EU clinical trial 2025-524751-32-00: Combined impact of cardiovascular polypill treatment and a specific nurse education program on adherence to therapy in patients with ACS: a randomized study
Protocol code: Epic49
Sponsor: Fundacion Epic (Educational Institution). Phase: Therapeutic use (Phase IV). Countries: Spain (authorised, recruitment pending).
Therapeutic area(s): Diseases [C] - Cardiovascular Diseases [C14]
Gender: Female, Male. Age: 18-64 years, 65+ years. Enrolment: 216.
Status: Authorised, recruitment pending. Decision date: 2026-03-30. Results received: No. Last updated: 2026-03-30.

Condition(s): Acute coronary syndrome
Product: Trinomia 100 mg/40 mg/2,5 mg cápsulas duras., Acovil 10 mg comprimidos, Cardyl 40 mg comprimidos recubiertos con película, Adiro 100 mg comprimidos gastrorresistentes EFG

Primary endpoint: Adherence will be assessed at the coordinating center one year after admission. A combined evaluation of adherence will be conducted using four methods: Morisky Green, Haynes-Sackett, attendance at follow-up visits, and pharmacy medication pick-up. Patients will be considered adherent if they meet the adherence criteria for all four methods used. The assessment of therapeutic adherence will be performed by a nursing team blinded to the patient’s assigned treatment group, to minimize bias
Endpoint(s): Analysis of drug levels, Control of cardiovascular risk factors, Quality of life, Functional capacity for basic activities of daily living (ADLs), Ability to perform instrumental activities of daily living (IADLs), Cognitive status

Source: https://euclinicaltrials.eu/ctis-public/view/2025-524751-32-00